EU clinical trial 2024-513227-16-00: A Phase 3, Randomized, Double-blind, Placebo-controlled Study of Atrasentan in Patients with IgA Nephropathy at Risk of Progressive Loss of Renal Function (The ALIGN Study)
Protocol code: CEXV811A12301
Sponsor: Novartis Pharma AG (Pharmaceutical company). Phase: Therapeutic confirmatory (Phase III). Countries: Germany (ongoing, recruitment ended), Portugal (ongoing, recruiting), Italy (ongoing, recruitment ended), Spain (ongoing, recruiting), France (authorised, recruiting), Poland (ongoing, recruiting).
Therapeutic area(s): Diseases [C] - Immune System Diseases [C20]
Gender: Female, Male. Age: 18-64 years, 65+ years. Enrolment: 42.
Start date (EU): 2021-05-19. Decision date: 2024-08-20. Results received: No. Last updated: 2026-08-07.
Decision dates by country: IT: 2024-09-10, FR: 2024-09-05, PL: 2024-10-02, DE: 2024-08-27, ES: 2024-08-20, PT: 2024-08-28

Condition(s): Immunoglobulin A Nephropathy (IgAN)
Product: Placebo - Film coated tablet for oral use, atrasentan, Bion 1301/FUB523

Primary endpoint: The change in proteinuria (urine protein:creatinine ratio [UPCR] based on 24-hour urine collection) from baseline to Week 36 (non-SGLT2i stratum)., Sub study: Type, incidence, severity, seriousness, and relatedness of treatment-emergent adverse events (TEAEs), Sub study: Incidence, severity, seriousness, and relatedness of adverse events of special interest (AESI) including events of fluid overload and infection
Endpoint(s): Change from baseline to final study visit (Week 136, 4 weeks post end of treatment) in eGFR, using the chronic kidney disease-epidemiology collaboration (CKD-EPI) creatinine equation (non-SGLT2i stratum), Percent of subjects meeting the composite endpoint of experiencing at least one of the following during the study (non-SGLT2i stratum): 1) At least a 30% reduction in eGFR sustained for at least 30 days, 2) eGFR <15 mL/min/1.73m2, sustained for at least 30 days, 3) Chronic dialysis, ≥30 days, 4) Kidney transplantation, 5) All-cause mortality, Percent of subjects achieving reduction of proteinuria to < 1 g/day at Week 36 and a 25% decrease in total urine protein from Baseline (non-SGLT2i stratum)., Open Label Extension: Change from OL Baseline to OL Week 36 in UPCR based on 24-hour urine collection, Open Label Extension: Change from OL Baseline to OL Week 52 in eGFR, using the chronic kidney disease-epidemiology collaboration (CKD-EPI) creatinine equation, Sub study: Change from substudy Baseline to substudy Week 48 in UPCR based on 24-hour urine collection, Sub study: Change from substudy Baseline to substudy Week 48 in eGFR, using the chronic kidney disease-epidemiology collaboration (CKD-EPI) creatinine equation

Source: https://euclinicaltrials.eu/ctis-public/view/2024-513227-16-00